EU clinical trial 2025-523737-26-00: A Pilot, Randomized, Double-blind, Placebo-controlled Trial to Evaluate the Tolerability, Safety, and Pharmacokinetics of a Single Intra-articular Injection of CNTX-0066 in Participants with Chronic, Moderate-to-Severe Osteoarthritis Knee Pain
Protocol code: CNTX-0066-OAi-101
Sponsor: Centrexion Therapeutics Corp. (Pharmaceutical company). Phase: Human Pharmacology (Phase I)- Other. Countries: Denmark (authorised, recruitment pending).
Therapeutic area(s): Diseases [C] - Musculoskeletal Diseases [C05]
Gender: Female, Male. Age: 18-64 years, 65+ years. Enrolment: 20.
Status: Authorised, recruitment pending. Decision date: 2026-02-24. Results received: No. Last updated: 2026-02-24.

Condition(s): Osteoarthritis of the knee

Source: https://euclinicaltrials.eu/ctis-public/view/2025-523737-26-00